EU clinical trial 2025-522320-27-00: A trial to evaluate the absolute bioavailability of cenerimod in healthy male participants
Protocol code: ID-064-108
Sponsor: Viatris Innovation GmbH (Pharmaceutical company). Phase: Human Pharmacology (Phase I)- Other. Countries: Netherlands (ended).
Therapeutic area(s): Not possible to specify
Gender: Male. Age: 18-64 years, 65+ years. Enrolment: 6.
Status: Ended. Start date (EU): 2025-11-17. End date (EU): 2026-03-18. Decision date: 2025-11-07. Results received: No. Last updated: 2025-11-07.

Condition(s): Not applicable - healthy volunteer trial

Source: https://euclinicaltrials.eu/ctis-public/view/2025-522320-27-00